EU clinical trial 2024-512194-27-01: Short-term interruption versus continuous anticoagulation in colorectal polypectomy. A randomized multicenter investigator-initiated non-inferiority clinical trial: the POLYPHEM trial.
Sponsor: Hospital Universitario Ramon Y Cajal (Hospital/Clinic/Other health care facility). Phase: Therapeutic use (Phase IV). Countries: Spain (ongoing, recruiting).
Therapeutic area(s): Diseases [C] - Digestive System Diseases [C06]; Analytical,Diagnostic,Therapeutic Techniques and Equipment [E]-Surgical Procedures, Operative [E04]
Gender: Female, Male. Age: 18-64 years, 65+ years. Enrolment: 394.
Status: Ongoing, recruiting. Start date (EU): 2024-10-21. Decision date: 2024-06-18. Results received: No. Last updated: 2026-02-23.

Condition(s): Patients receiving oral anticoagulant therapy who are scheduled for elective colonoscopy for any indication.
Product: ACENOCOUMAROL, EDOXABAN, WARFARIN, APIXABAN, RIVAROXABAN, DABIGATRAN ETEXILATE

Primary endpoint: Occurrence of haemorrhage events post-polypectomy
Endpoint(s): Occurrence of thromboembolic events post-polypectomy, Carbon footprint associated with each intervention arm of the clinical trial

Source: https://euclinicaltrials.eu/ctis-public/view/2024-512194-27-01